EU clinical trial 2023-503320-89-00: A Study to Explore the Safety, Tolerability, Pharmacokinetic Profile, and Potential Efficacy of Guanabenz in Patients With Early-Childhood Onset Vanishing White Matter (VWM)
Protocol code: VWM1
Sponsor: Amsterdam UMC (Hospital/Clinic/Other health care facility). Phase: Phase I and Phase II (Integrated)- Other. Countries: Netherlands (ended).
Therapeutic area(s): Diseases [C] - Nervous System Diseases [C10]
Gender: Female, Male. Age: 0-17 years. Enrolment: 40.
Status: Ended. Start date (EU): 2021-05-31. End date (EU): 2025-12-29. Decision date: 2024-09-26. Results received: Yes. Last updated: 2025-11-20.

Condition(s): Vanishing White Matter
Product: Guanabenz capsule 2 mg in 180 mg blend 1, Guanabenz capsule 8 mg in 160 mg blend 2, Guanabenz capsule 6 mg in 120 mg blend 2, Guanabenz capsule 24 mg in 480 mg blend 2, Guanabenz capsule 1 mg in 90 mg blend 1, Guanabenz capsule 16 mg in 320 mg blend 2, Guanabenz capsule 4 mg in 360 mg blend 1

Primary endpoint: All adverse events and serious adverse events collected from the start of study treatment until the end of the study, applying the most recent version of the National Cancer Institute (NCI) Common Terminology Criteria for Adverse Events (CTCAE, version 5.0, 27-Nov-2017), as well as applying
Endpoint(s): Guanabenz PK parameters in plasma, such as Cmax, AUC, half-life, and predicted trough concentration (Ctrough) at steady state, Quantitative brain MRI parameters:, Clinical parameters:, Overall survival

Source: https://euclinicaltrials.eu/ctis-public/view/2023-503320-89-00